EU clinical trial 2024-518510-87-00: Additive Benefits of Semaglutide for open-AngLe glaucoma – an Opportunity for Neuroprotection (ABSALON)
Sponsor: Rigshospitalet (Hospital/Clinic/Other health care facility). Phase: Therapeutic use (Phase IV). Countries: Denmark (ongoing, recruiting).
Therapeutic area(s): Diseases [C] - Eye Diseases [C11]
Gender: Female, Male. Age: 18-64 years, 65+ years. Enrolment: 126.
Status: Ongoing, recruiting. Start date (EU): 2025-04-10. Decision date: 2024-11-15. Results received: No. Last updated: 2024-11-15.

Condition(s): Glaucoma
Product: Rybelsus 14 mg tablets, Rybelsus 3 mg tablets, The tablets will be identical. The clinic variants of oral semaglutide 3 mg, 7 mg, 14 mg and placebo are produced with the tablet debossment ‘M8’ in 7 tablet blister packs with no colour on forming foil and no print on lid foil. The marketed Rybelsus® tablets are produced with the tablet debossment ‘3’, ‘7’ or ‘14’ on one side and ‘NOVO’ on the other side in 10 tablet blisters with coloured forming foil and print on lid foil. The differences have no impact on the stability of the product. The treatment/placebo tablets are dispensed by unblinded staff to ensure blinding of the investigator. Labeling will be in accordance with EU CTR Annex VI, local regulations, and study requirements., Rybelsus 7 mg tablets

Primary endpoint: Change in the inner retinal function assessed by mean change in the photopic negative response of the electroretinogram between baseline and month 6.
Endpoint(s): Change in the inner retinal function assessed by mean change in the photopic negative response of the electroretinogram between baseline and month 3., Functional glaucoma progression assessed using the Pelli-Robson chart contrast sensitivity test., Health-related quality of life (HRQoL) assessed using two standardized validated questionnaires administered in Danish; the European Quality of life – 5 Dimensions – 3 Levels (EQ-5D-3L) questionnaire and the 25-item National Eye Institute Visual Function Questionnaire (NEI VFQ-25)., Safety and tolerance of oral semaglutide treatment in patients with glaucoma assessed by incidence of treatment emergent adverse events (TEAEs) and changes in safety-related blood analysis.

Source: https://euclinicaltrials.eu/ctis-public/view/2024-518510-87-00